EU clinical trial 2023-504733-53-00: A Phase II, multi-site, open-label, dose-titration trial to investigate the safety, tolerability, pharmacokinetics, and efficacy of Lu AG13909 in adults with Cushing’s disease
Protocol code: 20433A
Sponsor: H. Lundbeck A/S (Pharmaceutical company). Phase: Therapeutic exploratory (Phase II). Countries: Hungary (ongoing, recruiting), Spain (authorised, recruitment pending), France (ongoing, recruiting), Romania (ongoing, recruiting), Italy (ongoing, recruiting), Poland (ongoing, recruiting).
Therapeutic area(s): Diseases [C] - Congenital, Hereditary, and Neonatal Diseases and Abnormalities [C16]
Gender: Female, Male. Age: 18-64 years, 65+ years. Enrolment: 12.
Start date (EU): 2024-09-26. Decision date: 2024-07-15. Results received: No. Last updated: 2026-04-10.
Decision dates by country: HU: 2024-07-16, IT: 2024-07-16, RO: 2024-07-22, PL: 2024-07-22, FR: 2024-07-18, ES: 2024-07-15

Condition(s): Cushing's Disease

Primary endpoint: Part A & Part B: Urinary Free Cortisol (UFC) Complete Response: mean UFC (mUFC) ≤ Upper Limit of Normal (ULN) at the end of the IV/SC Titration Period [ Time Frame: Up to 490 days ], Number of Participants With Treatment-Emergent Adverse Events (TEAEs) [ Time Frame: Up to 1023 days ], PK endpoint: Part A Only: Cmax: Maximum Observed Plasma Concentration of Lu AG13909 [ Time Frame: Up to 323 days ], PK endpoint: Part A Only: Tmax: Nominal Time Corresponding to the Occurrence of Cmax of Lu AG13909 [ Time Frame: Up to 323 days ], PK endpoint: Part A & Part B: Ctrough: Minimum Observed Concentration of Lu AG13909 [ Time Frame: Up to 659 days ], PK endpoint: Part A & Part B: Ttrough: Nominal Time Corresponding to the Occurrence of Ctrough [ Time Frame: Up to 659 days ], PK endpoint: AUC0-tau,ss: Area Under the Plasma Concentration Curve of Lu AG13909 at Steady State [ Time Frame: Up to 1037 days ], PK endpoint: CL: Systemic Clearance of Lu AG13909 [ Time Frame: Up to 1037 days ], PK endpoint: t½: Elimination Half-life of Lu AG13909 [ Time Frame: Up to 1037 days ], PK endpoint: Vd: Apparent Volume of Distribution of Lu AG13909 [ Time Frame: Up to 1037 days ], PK endpoint: SC Bioavailability (F) of Lu AG13909 [ Time Frame: Up to 1037 days ]

Source: https://euclinicaltrials.eu/ctis-public/view/2023-504733-53-00